EU clinical trial 2023-505603-23-00: A Study to Learn How Different Manufactured Products of the Study Medicine Called Ritlecitinib are Taken up Into the Blood in Healthy Adults When Taken on an Empty Stomach or When Taken With a Meal in Healthy Adults.
Protocol code: B7981086
Sponsor: Pfizer Inc. (Pharmaceutical company). Phase: Human Pharmacology (Phase I)- Other. Countries: Belgium (ended).
Therapeutic area(s): Diseases [C] - Immune System Diseases [C20]; Diseases [C] - Digestive System Diseases [C06]; Diseases [C] - Skin and Connective Tissue Diseases [C17]
Gender: Female, Male. Age: 18-64 years, 65+ years. Enrolment: 12.
Status: Ended. Start date (EU): 2024-01-29. End date (EU): 2024-03-28. End date: 2024-03-29. Decision date: 2023-10-25. Results received: No. Last updated: 2024-03-25.

Condition(s): ulcerative colitis, Crohn’s Disease, alopecia areata, rheumatoid arthritis, vitiligo

Source: https://euclinicaltrials.eu/ctis-public/view/2023-505603-23-00